EU clinical trial 2024-513251-32-00: Role of contrast enhanced mammography with Iomeprol 400 mgI/ml (Iomeron, Bracco), in the identification of breast cancer: I3-MaC Study
Protocol code: I3-MaC Study
Sponsor: Azienda Ospedaliero-Universitaria Policlinico Umberto I (Hospital/Clinic/Other health care facility). Phase: Therapeutic use (Phase IV). Countries: Italy (not authorised).
Therapeutic area(s): Analytical, Diagnostic and Therapeutic Techniques and Equipment [E] - Diagnosis [E01]
Gender: Female. Age: 18-64 years. Enrolment: 173.
Status: Not authorised. Decision date: 2024-07-09. Results received: No. Last updated: 2024-07-09.

Condition(s): Breast cancer
Product: IOMEPROL

Primary endpoint: Main Parameters evaluations • Dose of contrast administered (mL) • Contrast flow rate (mL/s) • Creatinine • BUN • VFG • Serum Albumin • Na • K • eGFR
Endpoint(s): • Pre-CEM mammography and breast ultrasound • Follow-up mammography and breast ultrasound, 6 and 12 months after CEM

Source: https://euclinicaltrials.eu/ctis-public/view/2024-513251-32-00